EU clinical trial 2023-508355-39-00: Phase I/II study of anti-CD7 Chimeric Antigen Receptor-Expressing T cells in pediatric patients/young adult affected by relapsed/refractory CD7+ T-cell Acute Lymphoblastic Leukemia/Lymphoma
Protocol code: CD7-CAR01
Sponsor: Ospedale Pediatrico Bambino Gesu' (Hospital/Clinic/Other health care facility). Phase: Phase I and Phase II (Integrated)- First administration to humans. Countries: Italy (ongoing, recruiting).
Therapeutic area(s): Diseases [C] - Hemic and Lymphatic Diseases [C15]
Gender: Female, Male. Age: 0-17 years, 18-64 years. Enrolment: 26.
Status: Ongoing, recruiting. Start date (EU): 2024-04-20. Decision date: 2024-04-18. Results received: No. Last updated: 2026-07-31.

Condition(s): Relapsed/refractory CD7+ T-cell Acute Lymphoblastic Leukemia/Lymphoma
Product: Fludara 50 mg powder for solution for injection or infusion., Cyclophosphamide Injection 1 g.

Primary endpoint: Phase I primary end-points • To evaluate the safety of the infusion of CD7-CART01 at 2 different escalating doses (1.0 x 106 and 3.0 x 106 cells/kg recipient total body weight of CAR+ T cells) and establish the dose-limiting toxicity (DLT) of the cellular product. DLT will be defined as any of the following that is not pre-existing, due to infection or to underlying malignancy, occurring in the first 28 days after infusion, and that may be considered possibly, probably or definitely related to t, Phase II primary end-points 1. To assess the antitumor effect of CD7-CART01 at day 28 post-infusion by determining BM, PB and CSF morphological response and MRD. In particular, the primary end-point will be the proportion of patients achieving either morphological complete remission (CR) or CR with incomplete blood count recovery (CRi) and with minimal residual disease (MRD) negativity at day 28 (defined as a value < 1x10-4).
Endpoint(s): Phase I and II secondary end-points: 1. To confirm the safety of the approach, using the recommended dose defined during the Phase I portion of the study. 2. To assess the Overall Response Rate (ORR) at day 28, which includes MRD-negative CR, CR and CR with incomplete blood count recovery (CRi). Only for patients with LL, the percentage of responders will be defined by a reduction of the tumor masses >35% at day+33 and blasts percentage <5% in the BM and absence of blasts in the CSF.

Source: https://euclinicaltrials.eu/ctis-public/view/2023-508355-39-00